EU clinical trial 2023-507777-18-00: TELLOMAK: T-cell Lymphoma anti-KIR3DL2 therapy. An open label, multi-cohort, multi-center phase II study evaluating the efficacy and safety of IPH4102 alone or in combination with chemotherapy in patients with advanced T-cell lymphoma.
Protocol code: IPH4102-201
Sponsor: Innate Pharma (Pharmaceutical company). Phase: Therapeutic exploratory (Phase II). Countries: France (ended), Belgium (ended), Spain (ended), Poland (ended), Italy (ended), Germany (ended).
Therapeutic area(s): Diseases [C] - Neoplasms [C04]
Gender: Female, Male. Age: 18-64 years, 65+ years. Enrolment: 104.
Status: Ended. Start date (EU): 2019-03-19. End date (EU): 2025-12-23. Decision date: 2024-04-30. Results received: No. Last updated: 2025-08-04.
Decision dates by country: ES: 2024-04-30, BE: 2024-05-02, FR: 2024-05-06, DE: 2024-05-01, IT: 2024-05-13, PL: 2024-05-16

Condition(s): Advanced T-Cell Lymphomas (TCL), i.e. Cutaneous T Cell Lymphomas (CTCL) CTCL subtypes under investigation: relapsed/refractory Sézary Syndrome (SS), stage IB to IV Mycosis Fungoides (MF).
Product: Lacutamab

Primary endpoint: Objective response rate (ORR). ORR is defined as the proportion of patients with complete or partial response.
Endpoint(s): 1. Safety Assessment: - AEs, SAEs, change in clinical laboratory evaluations and vital signs., 3. Quality of life: obtained with the patient-reported VAS score for pruritus and QoL questionnaire SkinDex29., 4. Pharmacokinetic (PK) Assessment: Individual IPH4102 serum concentration., 5. Immunogenic potential of IPH4102: Immunogenicity results for each patient., 2.a. Other antitumor activity endpoints: - Duration of response measured from the first documentation of objective response (if subsequently confirmed) to the event of disease progression or death., 2.b. Other antitumor activity endpoints: - Objective response rate (ORR) review of disease response by central review (Cohort 1 only)., 2.c. Other antitumor activity endpoints: - Progression free survival (PFS) from the start of IPH4102 administration to documented progression or death from any cause., 2.d. Other antitumor activity endpoints: - Overall Survival (OS) measured from the start of IPH4102 administration to death from any cause.

Source: https://euclinicaltrials.eu/ctis-public/view/2023-507777-18-00